EU clinical trial 2024-513665-40-00: Randomized, open-label, single dose, two-period, two-treatment, cross-over bioequivalence study comparing test product Rivaroxaban/Acetylsalicylic acid, tablet, 2.5 mg/50 mg (given as two tablets) to reference product Xarelto 2.5 mg film-coated tablets (given as two tablets) and Aspirin® N 100 mg tablet in healthy male and female subjects under fasting conditions.
Sponsor: Adamed Pharma S.A. (Pharmaceutical company). Phase: Human Pharmacology (Phase I)- Bioequivalence Study. Countries: Czechia (ended).
Therapeutic area(s): Diseases [C] - Cardiovascular Diseases [C14]
Gender: Female, Male. Age: 18-64 years. Enrolment: 62.
Status: Ended. Start date (EU): 2024-06-25. End date (EU): 2025-03-26. Decision date: 2024-06-13. Results received: No. Last updated: 2025-02-10.

Condition(s): not applicable (submitted trial is a bioequivalence in healthy subjects)

Source: https://euclinicaltrials.eu/ctis-public/view/2024-513665-40-00